EU clinical trial 2024-515281-14-00: An open-label, multicenter, roll-over study for patients who have completed a prior Novartis-sponsored sabatolimab (MBG453) study and are judged by the investigator to benefit from continued treatment with sabatolimab
Protocol code: CMBG453B12206B
Sponsor: Novartis Pharma AG (Pharmaceutical company). Phase: Therapeutic exploratory (Phase II). Countries: Spain (ongoing, recruitment ended), Greece (ongoing, recruitment ended), France (ongoing, recruitment ended), Czechia (ongoing, recruitment ended), Germany (ended), Italy (ongoing, recruitment ended).
Therapeutic area(s): Diseases [C] - Neoplasms [C04]
Gender: Female, Male. Age: 0-17 years, 18-64 years, 65+ years. Enrolment: 18.
Start date (EU): 2023-02-13. Decision date: 2024-09-16. Results received: No. Last updated: 2026-04-21.
Decision dates by country: DE: 2024-09-20, FR: 2024-09-17, IT: 2024-10-28, ES: 2024-09-16, CZ: 2024-09-20, GR: 2024-09-20

Condition(s): intermediate, high or very high risk MDS in adult patients chronic Myelomonocytic Leukemia - 2 (CMML-2) Acute Myeloid Leukemia (AML) in adult patients unfit for chemotherapy
Product: MBG453, VENETOCLAX, VENETOCLAX, AZACITIDINE, VENETOCLAX

Primary endpoint: Frequency and severity of AEs and SAEs
Endpoint(s): Duration of exposure to sabatolimab

Source: https://euclinicaltrials.eu/ctis-public/view/2024-515281-14-00